EU clinical trial 2023-505664-11-00: An Open-Label Trial to Assess the Comparative Bioavailability of TV-44749 to Oral Olanzapine in Participants with Schizophrenia
Protocol code: TV44749-BA-10196
Sponsor: Teva Branded Pharmaceutical Products R&D LLC (Pharmaceutical company). Phase: Human Pharmacology (Phase I)- Other. Countries: Germany (ended), Spain (ended), France (not authorised), Croatia (ended).
Therapeutic area(s): Psychiatry and Psychology [F] - Mental Disorders [F03]
Gender: Female, Male. Age: 18-64 years. Enrolment: 18.
Status: Ended. Start date (EU): 2024-06-19. End date (EU): 2025-08-11. End date: 2025-09-04. Decision date: 2024-05-07. Results received: No. Last updated: 2025-08-27.
Decision dates by country: FR: 2024-05-14, DE: 2024-05-08, HR: 2024-05-09, ES: 2024-05-07

Condition(s): Schizophrenia

Source: https://euclinicaltrials.eu/ctis-public/view/2023-505664-11-00